EU clinical trial 2024-517514-15-00: An open-label extension study evaluating the safety of zagociguat in participants with MELAS who completed TIS6463-203
Protocol code: TIS6463-204
Sponsor: Tisento Therapeutics Inc. (Laboratory/Research/Testing facility). Phase: Therapeutic exploratory (Phase II). Countries: Italy (ongoing, recruitment ended), Germany (ongoing, recruitment ended).
Therapeutic area(s): Not possible to specify
Gender: Female, Male. Age: 18-64 years, 65+ years. Enrolment: 14.
Status: Ongoing, recruitment ended. Start date (EU): 2025-12-18. Decision date: 2025-04-16. Results received: No. Last updated: 2026-07-27.
Decision dates by country: IT: 2025-04-16, DE: 2025-04-16

Condition(s): Mitochondrial encephalomyopathy, lactic acidosis, and stroke-like episodes (MELAS)
Product: zagociguat 15 mg

Primary endpoint: Incidence of treatment-emergent adverse events (TEAEs)
Endpoint(s): Vital sign measurements, ECG assessments, clinical laboratory tests, and C-SSRS responses at each scheduled timepoint, DEXA hip and lumbar spine BMD at each scheduled timepoint, Concentrations of CTX and P1NP at each scheduled timepoint, Incidence of SLE. Time to first SLE from Day 1, NMDAS scores at each scheduled timepoint, Concentrations of lactate, GDF-15, FGF-21, B2M, serum amyloid P component, TNFR-2, vWF, ICAM-1, NfL, and VCAM-1 at each scheduled timepoint, CGI-C overall MELAS scale score at each scheduled timepoint, eGFR and UACR at each scheduled timepoint, HbA1c level at each scheduled timepoint, Concentrations of troponin I, NT-proBNP, and creatine kinase (CK)-MB at each scheduled timepoint, Exploratory pharmacokinetics: Concentrations of zagociguat at each scheduled time point

Source: https://euclinicaltrials.eu/ctis-public/view/2024-517514-15-00